EU clinical trial 2024-516611-24-00: A trial to learn how ceralasertib affects the way certain medications move throughout the body over time and how safe it is to use ceralasertib with these medications in adults with advanced solid tumors
Protocol code: D533BC00003
Sponsor: AstraZeneca AB (Pharmaceutical company). Phase: Human Pharmacology (Phase I)- Other. Countries: Spain (not authorised).
Therapeutic area(s): Diseases [C] - Neoplasms [C04]
Gender: Female, Male. Age: 18-64 years, 65+ years. Enrolment: 18.
Status: Not authorised. Decision date: 2025-05-13. Results received: No. Last updated: 2025-05-13.

Condition(s): Advanced solid tumour

Source: https://euclinicaltrials.eu/ctis-public/view/2024-516611-24-00